EU clinical trial 2023-505214-23-00: PRODIGE 87 FOXTROT II : Personalising and refining neo-adjuvant chemotherapy in locally advanced but resectable colon cancer in the elderly of 70 years old or more
Sponsor: Centre Hospitalier Universitaire De Dijon (Hospital/Clinic/Other health care facility). Phase: Therapeutic confirmatory (Phase III). Countries: France (ongoing, recruiting).
Therapeutic area(s): Diseases [C] - Digestive System Diseases [C06]
Gender: Female, Male. Age: 65+ years. Enrolment: 150.
Status: Ongoing, recruiting. Start date (EU): 2024-06-07. Decision date: 2023-08-03. Results received: No. Last updated: 2026-03-09.

Condition(s): colon carcinoma
Product: FLUOROURACIL, FOLINIC ACID, FLUOROURACIL, OXALIPLATIN

Primary endpoint: Disease-free survival (DFS), is defined as the time from randomization to the first event (i.e, either a first recurrence local or metastatic), treatment failure, or death from any cause.
Endpoint(s): Histopathological evaluation: histopathologic description will be made by evaluating the following criteria: FIT, SIR, tumor cell density, maximum tumor size, depth of invasion, apical node involvement, peritoneal involvement, lymph node involvement, R1/R2 resection rate, Short-term efficacy assessment of disease stage reduction following neoadjuvant chemotherapy within one year after surgery., Safety and toxicity: Will be assessed by treatment-related toxicities according to NCI-CTCAE version 5.0., Overall and cancer-specific survival: defined as the time from the date of randomisation to the date of death from any cause for overall survival, and related to the cancer disease for cancer-specific survival. Patients alive will be censored at their last news., Rate of surgical morbidity defined as the percentage of grade I/II/IV/V complications according to the Clavien-Dindo classification, will be assessed early, between 4 and 12 weeks after surgery, and late, up to one year after surgery, Post-operative mortality defined as any death within 90 days after surgery or within the hospital stay, The presence and absence of adjuvant chemotherapy will be described, Quality of life will be assessed using the cancer-specific QLQ-C30 and colon cancer-specific QLQ-CR29 questionnaires and the EQ-5D-5L questionnaire. Elderly EORTC module QLQ-QLD14 will also be used, Geriatric assessment will be performed by the following questionnaires: G8, IADL, ADL, functional domain and G-code. The health of the elderly will be explored and assessed through these tools, at baseline, in the 12 weeks following surgery, at 1 year after surgery and 3 years after surgery

Source: https://euclinicaltrials.eu/ctis-public/view/2023-505214-23-00